EU clinical trial 2024-517842-33-01: A phase IB clinical trial on neoadjuvant and intraoperative intracranial administration of triple immune checkpoint blockade plus myeloid dendritic cells in patients with recurrent high-grade glioma
Sponsor: UZ Brussel (Hospital/Clinic/Other health care facility). Phase: Human Pharmacology (Phase I)- Other. Countries: Belgium (ongoing, recruiting).
Therapeutic area(s): Diseases [C] - Pathological Conditions, Signs and Symptoms [C23]
Gender: Female, Male. Age: 18-64 years, 65+ years. Enrolment: 113.
Status: Ongoing, recruiting. Start date (EU): 2024-11-20. Decision date: 2024-11-20. Results received: No. Last updated: 2026-03-03.

Condition(s): glioblastoma, astrocytoma
Product: YERVOY 5 mg/ml concentrate for solution for infusion, Autologous CD1c(BDCA-1)+/CD141(BDCA-3)+ myDC cell product, Opdualag 240 mg/80 mg concentrate for solution for infusion, OPDIVO 10 mg/mL concentrate for solution for infusion.

Primary endpoint: Incidence of adverse events (AE) that will be collected on a continuous basis. Type, frequency, and severity will be reported descriptively and graded according to Common Terminology Criteria for Adverse Events version 5 (CTCAEv5).
Endpoint(s): Progression-free survival (PFS); defined as the time from the date of the first neoadjuvant dose administration during the stereotactic biopsy until the earliest date of documented disease progression or death due to any cause estimated by Kaplan-Meier survival estimates; including median, 6- months- and yearly survival rates with 95% confidence intervals., Overall survival (OS); defined as the time from the date of the first neoadjuvant dose administration during the stereotactic biopsy until the date of death due to any cause estimated by Kaplan-Meier survival estimates; including median, 6- months- and yearly survival rates with 95% confidence intervals., Assessment of the neuro-cognitive function, psycho-emotional disturbances and HR-QoL during study treatment at baseline, in week 27, and every 26 weeks thereafter until progression of disease, death, withdrawal of consent, or lost to follow-up.

Source: https://euclinicaltrials.eu/ctis-public/view/2024-517842-33-01